EU clinical trial 2024-511085-37-00: Safety and Efficacy of Pramipexole Treatment in Resistant Obsessive-Compulsive Disorder (OCD): Pilot, Randomized and Controlled Clinical Trial
Protocol code: OCD-RT
Sponsor: CCAB Centro Clinico Academico Braga Associacao (Pharmaceutical company). Phase: Therapeutic exploratory (Phase II). Countries: Portugal (ongoing, recruiting).
Therapeutic area(s): Psychiatry and Psychology [F] - Mental Disorders [F03]
Gender: Female, Male. Age: 18-64 years. Enrolment: 48.
Status: Ongoing, recruiting. Start date (EU): 2024-08-19. Decision date: 2024-05-21. Results received: No. Last updated: 2026-03-02.

Condition(s): Obsessive-compulsive disorder (OCD)
Product: Pramipexol Aurobindo 0,35 mg tabletter, Pramipexol Aurobindo 0,088 mg Tabletten, Pramipexol Aurobindo 0,18 mg tabletter

Primary endpoint: Difference in the total score of the Y-BOCS scale between baseline (V1; before intervention with the investigational drug) and week 16 (V9; after intervention with the investigational drug), between the different groups treated with different doses of pramipexole.
Endpoint(s): Number of adverse events observed (nonserious, serious not related to the investigational medicinal product, and serious related to the investigational medicinal product) from day 2 (V1; after the first dose of the investigational medicinal product) to the week 24 (V11; end of study) in the different pramipexole treatment groups.

Source: https://euclinicaltrials.eu/ctis-public/view/2024-511085-37-00